EU clinical trial 2023-509584-24-01: Phase II study of pembrolizumab in combination with cisplatin or carboplatin and pemetrexed as induction chemo+immunotherapy in resectable epithelioid and biphasic pleural mesothelioma (CHIMERA study)
Protocol code: CHIMERA
Sponsor: Istituto Oncologico Veneto (Hospital/Clinic/Other health care facility). Phase: Therapeutic exploratory (Phase II). Countries: Italy (ongoing, recruitment ended).
Therapeutic area(s): Diseases [C] - Neoplasms [C04]
Gender: Female, Male. Age: 18-64 years, 65+ years. Enrolment: 40.
Status: Ongoing, recruitment ended. Start date (EU): 2024-11-06. Decision date: 2024-08-29. Results received: No. Last updated: 2025-11-21.

Condition(s): Malignant Pleural Mesothelioma
Product: KEYTRUDA 25 mg/mL concentrate for solution for infusion, PEMETREXED, CISPLATIN, CARBOPLATIN

Primary endpoint: Pathological complete response defined as 0% residual viable tumor cells in the primary tumor and in sampled lymph nodes, following neoadjuvant treatment as assessed by central pathology assessment. Patients who are not evaluable per central pathology assessment or who do not have a surgical specimen will be considered as non-pCR. Patients who received less than 2 cycles out of the planned 3 cycles of neoadjuvant therapy due to unacceptable toxicity will not be considered in the pCR evaluation.
Endpoint(s): Major pathological response defined as ≤10% residual viable tumor cells in the primary tumor and sampled lymph nodes after neoadjuvant treatment at the time of resection as assessed per central pathology laboratory. Patients who are not evaluable per central pathology assessment (including patients with R2 margins) or who do not have a surgical specimen will be considered as having non-mPR (eg, response captured as “non-evaluable” or “missing,” as appropriate)., Overall response rate defined as the sum of partial and complete response according to modified RECIST 1.1 criteria for Malignant Pleural Mesothelioma., Event free survival defined as the time from the start of treatment to any progression of disease precluding surgery, progression or recurrence of disease after surgery, progression of disease in the absence of surgery, or death from any cause., Overall survival defined as the time from the start of treatment to all-cause death., Feasibility in terms of: i) Resection rate: defined as the percentage of patients finally eligible for radical surgery, among those who receive at least one cycle of neoadjuvant treatment; ii) rate of patients who complete three cycles of neoadjuvant chemo-immunotherapy followed by radical surgery., Safety profile in terms of incidence and grade of adverse events; incidence of adverse events and serious adverse events; incidence of definitive interruptions of treatment because of any-cause adverse events and treatment-related adverse events according to Common Terminology Criteria for Adverse Events (CTCAE) version 5.0.

Source: https://euclinicaltrials.eu/ctis-public/view/2023-509584-24-01